EU clinical trial 2024-512161-14-00: An Ophthalmic Safety Study of New Investigational Drug in Breast Cancer Patients
Protocol code: D853AC00001
Sponsor: AstraZeneca AB (Pharmaceutical company). Phase: Human Pharmacology (Phase I)- Other. Countries: Belgium (ongoing, recruiting), Spain (ongoing, recruiting), Portugal (ongoing, recruiting), France (ended), Poland (ongoing, recruiting).
Therapeutic area(s): Diseases [C] - Neoplasms [C04]
Gender: Female, Male. Age: 18-64 years, 65+ years. Enrolment: 98.
Start date (EU): 2025-01-14. Decision date: 2024-11-05. Results received: No. Last updated: 2025-12-22.
Decision dates by country: BE: 2024-11-26, FR: 2024-11-05, PL: 2025-07-14, PT: 2024-11-07, ES: 2024-12-10

Condition(s): Breast Cancer

Source: https://euclinicaltrials.eu/ctis-public/view/2024-512161-14-00